EU clinical trial 2024-517506-29-00: Bioequivalence of two transdermal therapeutic systems delivering 100 mcg/h fentanyl
Protocol code: CLP24001
Sponsor: CCDRD Cooperative Clinical Drug Research and Development AG, Lavipharm S.A. (Pharmaceutical company). Phase: Human Pharmacology (Phase I)- Bioequivalence Study. Countries: Bulgaria (authorised, recruitment pending).
Therapeutic area(s): Diseases [C] - Pathological Conditions, Signs and Symptoms [C23]
Gender: Female, Male. Age: 18-64 years. Enrolment: 30.
Status: Authorised, recruitment pending. Decision date: 2025-04-03. Results received: No. Last updated: 2025-04-15.

Condition(s): Bioequivalence trial in healthy volunteers

Source: https://euclinicaltrials.eu/ctis-public/view/2024-517506-29-00